EU clinical trial 2022-502930-25-00: Multicentric randomized phase I/IIa trial of the safety and immunogenicity of a therapeutic HPV DC targeting vaccine in patients with Human papillomavirus (HPV)-positive oropharyngeal cancer (HPV.DCVax)
Protocol code: 2022/3459 HPV.DCVax
Sponsor: Institut Gustave Roussy (Hospital/Clinic/Other health care facility). Phase: Phase I and Phase II (Integrated)- First administration to humans. Countries: France (ended).
Therapeutic area(s): Diseases [C] - Neoplasms [C04]; Diseases [C] - Otorhinolaryngologic Diseases [C09]
Gender: Female, Male. Age: 18-64 years. Enrolment: 24.
Status: Ended. Start date (EU): 2023-07-31. End date (EU): 2026-03-27. Decision date: 2023-07-18. Results received: No. Last updated: 2025-10-08.

Condition(s): reduced risk of relapse of HPV-related oropharyngeal squamous cell carcinoma

Source: https://euclinicaltrials.eu/ctis-public/view/2022-502930-25-00